EU clinical trial 2024-515850-26-00: PET-DOPA Metabolic Detection and Characterization of Untreated Brain Metastases of Bronchial, Breast and Melanoma Cancer (DOPACER)
Protocol code: ICO-202-28 DOPACER
Sponsor: Institut De Cancerologie De L Ouest (Hospital/Clinic/Other health care facility). Phase: Therapeutic exploratory (Phase II). Countries: France (ended).
Therapeutic area(s): Diseases [C] - Neoplasms [C04]
Gender: Female, Male. Age: 18-64 years, 65+ years. Enrolment: 52.
Status: Ended. Start date (EU): 2021-12-03. End date (EU): 2025-12-03. Decision date: 2024-07-04. Results received: No. Last updated: 2024-12-10.
Decision dates by country: FR: 2024-09-19

Condition(s): patients with newly discovered brain metastases (non-small cell lung cancer, breast cancer or melanoma) measuring more than 5 mm and explored on MRI
Product: Dopacis 90 MBq/ml oplossing voor injectie

Primary endpoint: number of metastases detected on PET-DOPA compared to the number of metastases + 5 mm detected on MRI
Endpoint(s): a) The sensitivity of DOPA-PET is defined above (primary endpoint). Site-specific sensitivity will be calculated for 8 primary tumor categories: 3 for lung cancer (EGFR mutation or ALK rearrangement; PDL1+; others), 2 for melanoma (BRAF V600 mutation; others), 3 for breast cancer (triple negative; Her2+ RH-; others), b) Lesion characterization will be defined by SUVmax, SUVmean, tumor/brain background fixation ratio, tumor/striatum fixation ratio., c) Dynamic images are described with the analysis of activity-time curves (time to peak, slope of the curve from the 10th minute)., d) The 8 categories mentioned above will be considered for the classification of the operated MC

Source: https://euclinicaltrials.eu/ctis-public/view/2024-515850-26-00